EU clinical trial 2024-513682-40-01: A Phase 3, Randomized, open-label Study of Nivolumab + Relatlimab Fixed-dose Combination with Chemotherapy Versus Pembrolizumab with Chemotherapy as First-line Treatment for Participants with Non-squamous (NSQ), Stage IV or Recurrent Non-small Cell Lung Cancer and with Tumor Cell PD-L1 expression ≥1%
Protocol code: CA2241093
Sponsor: Bristol-Myers Squibb Services Unlimited Company (Pharmaceutical company). Phase: Therapeutic confirmatory (Phase III). Countries: Denmark (ongoing, recruiting), Poland (authorised, recruiting), Netherlands (ongoing, recruiting), Romania (ongoing, recruiting), Austria (ongoing, recruiting), Italy (ongoing, recruiting), Germany (ongoing, recruiting), Portugal (ongoing, recruiting), Spain (ongoing, recruiting), Ireland (ongoing, recruiting), Belgium (ongoing, recruiting), France (ongoing, recruiting).
Therapeutic area(s): Diseases [C] - Neoplasms [C04]
Gender: Female, Male. Age: 18-64 years, 65+ years. Enrolment: 288.
Start date (EU): 2025-07-04. Decision date: 2025-06-11. Results received: No. Last updated: 2026-04-27.
Decision dates by country: DE: 2025-06-12, RO: 2025-06-16, IE: 2025-06-23, DK: 2025-06-11, PL: 2025-06-16, PT: 2025-06-26, FR: 2025-06-11, BE: 2025-06-11, AT: 2025-06-11, ES: 2025-06-19, IT: 2025-06-23, NL: 2025-06-11

Condition(s): Non-squamous (NSQ), Stage IV or Recurrent Non-small Cell Lung Cancer
Product: PEMBROLIZUMAB, PEMETREXED DISODIUM, CISPLATIN, PEMETREXED DISODIUM, Relatlimab + Nivolumab Fixed Dose Combination (FDC), CARBOPLATIN

Primary endpoint: Comparison of overall survival in Arm A and Arm B participants.
Endpoint(s): Comparison of PFS in Arm A and Arm B participant, as well as evaluation of DoR and ORR in Arm A and B participants., Safety of study drugs administered will be evaluated, along with TTD

Source: https://euclinicaltrials.eu/ctis-public/view/2024-513682-40-01